EU clinical trial 2025-524305-32-00: RADICAL-IO: thRee cycles of immunotherApy without raDical therapy In mediCALly InOperable stage I non-small cell lung cancer
Protocol code: M25RIO
Sponsor: Het Nederlands Kanker Instituut-Antoni van Leeuwenhoek Ziekenhuis Stichting (Hospital/Clinic/Other health care facility). Phase: Therapeutic exploratory (Phase II). Countries: Netherlands (authorised, recruitment pending).
Therapeutic area(s): Diseases [C] - Respiratory Tract Diseases [C08]; Diseases [C] - Neoplasms [C04]
Gender: Female, Male. Age: 18-64 years, 65+ years. Enrolment: 30.
Status: Authorised, recruitment pending. Decision date: 2026-06-16. Results received: No. Last updated: 2026-07-27.
Decision dates by country: NL: 2026-07-27

Condition(s): Stage I non-small cell lung cancer
Product: LIBTAYO 350 mg concentrate for solution for infusion.

Primary endpoint: Time from first cemiplimab administration to disease recurrence/progression as per RECIST 1.1, fatal TRAEs or NSCLC-related death
Endpoint(s): Time from first cemiplimab administration to disease recurrence/progression as per RECIST 1.1 or death of any cause, Grade ≥3 TRAEs classified by NCI-CTCAE v5 up until 90 days after the last cemiplimab cycle, in particular pneumonitis, Rate of local radical therapy after disease recurrence, Objective response rate as per RECIST 1.1, Best objective response as per RECIST 1.1, Time between objective response to disease recurrence as per RECIST 1.1, Time from first cemiplimab administration to local, regional and distant disease recurrence/progression, Overall survival: Time from first cemiplimab administration to death of any cause, Disease-specific survival: Time from first cemiplimab administration to NSCLC-related death

Source: https://euclinicaltrials.eu/ctis-public/view/2025-524305-32-00